EU clinical trial 2024-515478-29-00: A proof of concept study with NVD-003, an autologous osteogenic bone graft, in the treatment of congenital pseudarthrosis of the tibia in pediatric patients.
Protocol code: NVD003-CLN02
Sponsor: Novadip Biosciences (Pharmaceutical company). Phase: Phase I and Phase II (Integrated)- Other. Countries: Belgium (ended).
Therapeutic area(s): Diseases [C] - Musculoskeletal Diseases [C05]; Diseases [C] - Congenital, Hereditary, and Neonatal Diseases and Abnormalities [C16]
Gender: Female, Male. Age: 0-17 years. Enrolment: 2.
Status: Ended. Start date (EU): 2022-11-28. End date (EU): 2026-03-19. Decision date: 2024-07-02. Results received: No. Last updated: 2025-07-24.

Condition(s): Congenital pseudarthrosis of the tibia
Product: NVD-003

Primary endpoint: Short term safety focusses on ATC and NVD 003 related (S)AEs between screening and 3 months post-GS (V6 included), Mid long-term safety focusses on the NVD 003 graft implantation, NVD 003 related (S)AEs and the surgical reintervention rate, including all corrective surgeries following a confirmed failure of the index surgery, captured between 3 months (V6 excluded) and 12 months post-GS (V8 included), Long-term safety evaluates the NVD 003 related SAEs between 12 months post-GS (V8 excluded) and 24 months (V9 included)
Endpoint(s): Based on CT-scan • Centrally analyze the tibial length difference at GS and 12 months post-GS • Centrally analyze the bone formation at 3-, 6-, and 12-months post GS • Centrally analyze bone union and remodeling at 12 months post-GS, Based on X-ray: • Centrally analyze the positioning of the graft at 6 weeks and 24 months post-GS • Centrally analyze the alignment of the concerned bones and fixation devices at 6 weeks and 24 months post-GS • Centrally evaluate bone growth based on tibial length evolution and leg length differences between both legs at 6 weeks and 24 months post-GS, Assess the clinical evolution of the patient, before and after the grafting surgery, by means of the investigator assessed “Clinical Global Impression”, Severity Scale (CGI-S) and Improvement Scale (CGI-I) at screening, at hospital discharge, 6 weeks, 3-, 6-, 12-, and 24-months post-grafting. a. CGI-S b. CGI-I:, a. CGI-S i. Screening: general functioning, walking ability, weight bearing, presence of pain and pain at palpation, appearance of the leg, social activities (including school attendance and sports activities)., b. CGI-I: i. Hospital discharge and 6 weeks post-GS: general functioning, presence of pain and pain at palpation, appearance of the leg ii. 3 months-24 months post-GS: general functioning, walking ability, weight bearing, presence of pain and pain at palpation, appearance of the leg, social activities (including school attendance and sports activities).

Source: https://euclinicaltrials.eu/ctis-public/view/2024-515478-29-00